EU clinical trial 2025-524896-22-00: A Randomized, Placebo-Controlled, Double-Blind, Parallel-Group, Multicenter Trial Evaluating the Effects of Two Dosing Regimens of Nolasiban on Uterine Contractility and Endocrine Parameters
Protocol code: RPN-NLS02
Sponsor: ReproNovo ApS (Pharmaceutical company). Phase: Therapeutic exploratory (Phase II). Countries: Spain (ongoing, recruiting).
Therapeutic area(s): Diseases [C] - Female Urogenital Diseases and Pregnancy Complications [C13]
Gender: Female. Age: 18-64 years. Enrolment: 120.
Status: Ongoing, recruiting. Start date (EU): 2026-06-05. Decision date: 2026-05-06. Results received: No. Last updated: 2026-05-22.
Decision dates by country: ES: 2026-05-11

Condition(s): Women with an indication for IVF/ICSI
Product: Product

Primary endpoint: Change in uterine contractility index from Day 1 to Day 4 of treatment

Source: https://euclinicaltrials.eu/ctis-public/view/2025-524896-22-00